EU clinical trial 2025-523086-22-00: An Open-Label, Multicenter, Phase 1 Trial to Evaluate the Safety, Pharmacokinetics, and Anti-Tumor Activity of TLN-372 as a Single Agent and in Combination with Other Anti-Tumor Agents, in Patients with Advanced KRAS Mutant Solid Tumors
Protocol code: TLN-372-2501
Sponsor: Treeline Biosciences Inc. (Pharmaceutical company). Phase: Phase I and Phase II (Integrated)- First administration to humans. Countries: Spain (ongoing, recruiting).
Therapeutic area(s): Diseases [C] - Neoplasms [C04]
Gender: Female, Male. Age: 18-64 years, 65+ years. Enrolment: 20.
Status: Ongoing, recruiting. Start date (EU): 2026-02-18. Decision date: 2026-01-07. Results received: No. Last updated: 2026-06-19.

Condition(s): Locally advanced or metastatic solid tumors
Product: TLN-372, TLN-372, Erbitux 5 mg/mL solution for infusion, Itraconazol – 1 A Pharma® 100 mg Hartkapseln, KEYTRUDA 25 mg/mL concentrate for solution for infusion.

Primary endpoint: Number of patients experiencing adverse events (AEs) that meet protocol-defined dose-limiting toxicity (DLT) criteria following administration of TLN-372, Incidence and severity of Treatment-Emergent Adverse Events (TEAEs) and Treatment-Related Adverse Events (TRAEs) leading to dose modification and discontinuation., Anti-tumor activity of TLN-372 by evaluating the objective response rate (ORR) according to the RESIST v1.1
Endpoint(s): Maximum observed plasma concentration (Cmax), time to peak drug concentration (Tmax), Minimum observed plasma concentration (Cmin), and Area Under the Plasma Concentration-Time Curve (AUC) of TLN-372, Anti-tumor activity of TLN-372 by evaluating the duration of response (DOR) as assessed by the time from the date of first objective response to the date of disease progression, Frequency of dose interruptions, reductions and dose intensity, Clinically significant ECG QT interval from baseline assessed as per NCI CTCAE v5.0, Clinically significant laboratory abnormalities from baseline in safety laboratory test results, assessed as per NCI CTCAE v5.0

Source: https://euclinicaltrials.eu/ctis-public/view/2025-523086-22-00